EU clinical trial 2023-506994-36-00: A Multicenter, Randomized, Double-Blind, Placebo Controlled 52-Week Maintenance and an Open-Label Extension Study of the Efficacy and Safety of Risankizumab in Subjects with Ulcerative Colitis
Protocol code: M16-066
Sponsor: AbbVie Deutschland GmbH & Co. KG (Pharmaceutical company). Phase: Therapeutic confirmatory (Phase III). Countries: Lithuania (ongoing, recruitment ended), Sweden (ongoing, recruitment ended), Bulgaria (ongoing, recruitment ended), Greece (ongoing, recruitment ended), Latvia (ongoing, recruitment ended), Slovakia (ongoing, recruitment ended), Poland (ongoing, recruitment ended), France (ongoing, recruitment ended), Portugal (ongoing, recruitment ended), Slovenia (ongoing, recruitment ended), Czechia (ongoing, recruitment ended), Belgium (ongoing, recruitment ended), Croatia (ongoing, recruitment ended), Austria (ongoing, recruitment ended), Netherlands (ongoing, recruitment ended), Italy (ongoing, recruitment ended), Romania (ongoing, recruitment ended), Spain (ongoing, recruitment ended), Germany (ongoing, recruitment ended).
Therapeutic area(s): Diseases [C] - Digestive System Diseases [C06]
Gender: Female, Male. Age: 0-17 years, 18-64 years, 65+ years. Enrolment: 544.
Status: Ongoing, recruitment ended. Start date (EU): 2018-10-11. Decision date: 2024-06-21. Results received: No. Last updated: 2026-04-27.
Decision dates by country: SI: 2024-07-01, FR: 2024-07-17, LV: 2024-06-21, BE: 2024-06-21, CZ: 2024-06-24, SK: 2024-06-21, DE: 2024-06-24, SE: 2024-06-24, IT: 2024-08-05, HR: 2024-06-25, ES: 2024-06-21, RO: 2024-06-26, LT: 2024-08-07, NL: 2024-06-24, PL: 2024-07-17, GR: 2024-07-22, BG: 2024-07-01, PT: 2024-06-26, AT: 2024-06-26

Condition(s): Ulcerative Colitis
Product: Risankizumab, Risankizumab placebo solution for infusion, ABBV-066 / Risankizumab, ABBV-066, Risankizumab placebo solution for injection in pre-filled syringe, Risankizumab

Primary endpoint: Sub-study 1 and 2: The achievement of clinical remission per Adapted Mayo score at Week 52, Sub-study 2: Selected efficacy endpoints as those listed in Sub-study 1 but comparing the Therapeutic Drug Monitoring vs Clinical Assessment arms as exploratory purpose., Sub-study 3: Evaluation of long-term safety, There are no efficacy endpoints for CTE.
Endpoint(s): The achievement of endoscopic improvement at Week 52., The achievement of histologic endoscopic improvement of the mucosa at Week 52., The achievement of endoscopic remission at Week 52., The achievement of clinical remission per Adapted Mayo score at Week 52 with no corticosteroid use for 90 days., The achievement of clinical remission per Adapted Mayo score at Week 52 in subjects with clinical remission at Week 0., The achievement of no bowel urgency at Week 52, The achievement of no abdominal pain at Week 52, The achievement of histologic endoscopic mucosal remission at Week 52., The achievement of endoscopic improvement at Week 52 in subjects with endoscopic improvement at Week 0., The achievement of clinical response per Adapted Mayo score at Week 52., Change from Baseline (of induction) to Week 52 in FACIT-Fatigue., Change from Baseline (of induction) to Week 52 in Inflammatory Bowel Disease Questionnaire (IBDQ) total score., The achievement of no nocturnal bowel movements at Week 52., The achievement of no tenesmus at Week 52., Change from Baseline (of induction) to Week 52 in number of fecal incontinence episodes per week., Change from Baseline (of induction) to Week 52 in number of days over a week with sleep interrupted due to UC symptoms., Exposure adjusted Occurrence of UC-related hospitalizations through Week 52

Source: https://euclinicaltrials.eu/ctis-public/view/2023-506994-36-00